EU clinical trial 2024-510596-37-01: Transdermal testosterone pretreatment in poor responders with androgen receptor polymorphism undergoing ICSI: A Randomized Clinical Investigation.
Sponsor: Instituto Bernabeu S.L. (Hospital/Clinic/Other health care facility). Phase: Therapeutic confirmatory (Phase III). Countries: Spain (authorised, recruitment pending).
Therapeutic area(s): Diseases [C] - Female Urogenital Diseases and Pregnancy Complications [C13]
Gender: Female. Age: 18-64 years. Enrolment: 100.
Status: Authorised, recruitment pending. Decision date: 2025-10-06. Results received: No. Last updated: 2026-02-18.

Condition(s): low ovarian reserve according to Bologna criteria and carriers of androgen receptor polymorphism
Product: Testosterone Gel 1%, Decapeptyl diario 0,1 mg polvo y disolvente para solución inyectable, Astarté 0,25 mg/0,5 ml solución inyectable en jeringa precargada EFG, Bemfola 300 IU/0.50 mL solution for injection in pre-filled pen, Bomba de gel transparente, donde la sustancia activa (testosterona) fue sustituida por agua purificada.

Primary endpoint: number of oocyte cumulus complexes obtained
Endpoint(s): Number of metaphase II stage oocytes obtained., Duration of stimulation (days), Dose of medication used, Fertilization rate, Blastocyst formation rate, Cancellation rate, Viable intrauterine gestation (confirmed by ultrasound)

Source: https://euclinicaltrials.eu/ctis-public/view/2024-510596-37-01